EU clinical trial 2024-519013-57-00: Phase I Study of PM534 to Patients with Advanced Solid Tumors
Protocol code: PM534-A-002-24
Sponsor: Pharma Mar S.A. (Pharmaceutical company). Phase: Phase I and Phase II (Integrated)- Other. Countries: Spain (ongoing, recruiting).
Therapeutic area(s): Diseases [C] - Neoplasms [C04]
Gender: Female, Male. Age: 18-64 years, 65+ years. Enrolment: 120.
Status: Ongoing, recruiting. Start date (EU): 2025-06-23. Decision date: 2025-04-14. Results received: No. Last updated: 2026-08-06.

Condition(s): Advances solid tumors

Source: https://euclinicaltrials.eu/ctis-public/view/2024-519013-57-00